EU clinical trial 2025-523841-82-00: A Phase 4 Pragmatic, Randomized Trial to Evaluate the Effectiveness and Safety of mRNA-1273 Variant-Containing Vaccine Formulation Against Severe Outcomes in Adults Aged 50-64 Years Without Risk Factors for Severe COVID-19 (DAN-COVID)
Protocol code: DAN-COVID
Sponsor: Gentofte Hospital, Moderna Inc. (Hospital/Clinic/Other health care facility, Pharmaceutical company). Phase: Therapeutic use (Phase IV). Countries: Denmark (ongoing, recruitment ended).
Therapeutic area(s): Diseases [C] - Virus Diseases [C02]
Gender: Female, Male. Age: 18-64 years. Enrolment: 275000.
Status: Ongoing, recruitment ended. Start date (EU): 2025-12-11. Decision date: 2025-11-26. Results received: No. Last updated: 2025-11-26.

Condition(s): SARS-CoV-2 infection
Product: Spikevax 50 micrograms dispersion for injection in pre-filled syringe COVID-19 mRNA Vaccine

Primary endpoint: Medically attended COVID-19, defined as a positive PCR test for SARS-CoV-2 or hospitalization for COVID-19-related respiratory tract disease. The prespecified registry-based definition of the primary endpoint is as follows: Medically attended COVID-19 (ICD-10 codes: B342, B972, U071) diagnosis type: A. Requires either a positive SARS-CoV-2 PCR test from the Danish Microbiology Database OR COVID-19-related hospitalization
Endpoint(s): 1. COVID-19-related hospitalization, 2. COVID-19-related respiratory tract disease hospitalization, 3. COVID-19-related cardio-respiratory disease hospitalization, 4. All-cause respiratory tract infection hospitalization, 5. All-cause cardio-respiratory hospitalization, 6. All-cause lower respiratory tract disease hospitalization, 7. All-cause hospitalization, 8. COVID-19 death, 9. All-cause death

Source: https://euclinicaltrials.eu/ctis-public/view/2025-523841-82-00